EU clinical trial 2023-506511-17-00: A double-blind, placebo-controlled pilot trial of BP1.4979 for the treatment of binge eating disorder.
Protocol code: P20-08 / BP1.4979
Sponsor: Bioprojet Pharma (Pharmaceutical company). Phase: Therapeutic exploratory (Phase II). Countries: France (ended), Spain (ended).
Therapeutic area(s): Psychiatry and Psychology [F] - Behavior and Behavior Mechanisms [F01]
Gender: Female. Age: 18-64 years, 65+ years. Enrolment: 86.
Status: Ended. Start date (EU): 2022-03-07. End date (EU): 2025-11-24. Decision date: 2023-10-19. Results received: No. Last updated: 2025-05-14.
Decision dates by country: ES: 2024-08-05, FR: 2023-10-19

Condition(s): Binge eating disorder
Product: Matching film-coated placebo tablet

Primary endpoint: The primary efficacy endpoint will be the change in the total number of binge-eating (BE) episodes per week based on the self-reported BE diaries, from the 2-week baseline (Day-14 to Day 0) compared to the last 2 weeks at the end of treatment period (Day 43 to Day 56).
Endpoint(s): Continuous Glucose Monitoring System (CGMS): to assess the number of dietary intakes (glycemic excursions) between meals identified as BE episodes by the Investigator., Change of the Yale Food Addiction Scale (YFAS) from baseline to Week 8., Change of the Clinical Global Impression (CGI) scale: CGI-Severity (CGI-S) and CGI-Improvement (CGI-I) from baseline to Week 8., Change in the number of BE days per week from baseline to Week 7 and Week 8.

Source: https://euclinicaltrials.eu/ctis-public/view/2023-506511-17-00